EU clinical trial 2022-501312-34-01: The Intertransverse Process Block - Single or Multiple Injection? A randomised, procedure related, blinded crossover trial in healthy volunteers
Protocol code: ZUH-ITP-MBCS
Sponsor: Zealand University Hospital (Hospital/Clinic/Other health care facility). Phase: Therapeutic use (Phase IV). Countries: Denmark (ended).
Therapeutic area(s): Analytical, Diagnostic and Therapeutic Techniques and Equipment [E] - Anesthesia and Analgesia [E03]; Analytical, Diagnostic and Therapeutic Techniques and Equipment [E] - Investigative Techniques [E05]
Gender: Male. Age: 18-64 years, 65+ years. Enrolment: 12.
Status: Ended. Start date (EU): 2023-02-26. End date (EU): 2023-03-08. Decision date: 2023-01-24. Results received: Yes. Last updated: 2023-01-24.

Condition(s): The ITP block is primarily used for pain amelioration after breast cancer surgery.
Product: ALFENTANIL, Ropivacain Fresenius Kabi 7,5 mg/ml, injektionsvätska, lösning

Primary endpoint: The primary outcome of this procedure related study is the number of anaesthetised thoracic dermatomes
Endpoint(s): “Sensory mapping”: the extent of cutaneous spread of the sensory block (area in cm2), To evaluate thermography in a clinical setup (the temperature differences between non-blockade side and blockade side), To evaluate changes in non-invasive blood pressure, To evaluate block application satisfaction in numeric rating scale pain scores

Source: https://euclinicaltrials.eu/ctis-public/view/2022-501312-34-01